EU clinical trial 2023-505154-18-00: C4801002 - A Phase 2, Randomized, Open-Label Trial to Describe the Safety and Immunogenicity of A Monovalent Pneumococcal Conjugate Candidate Administered As a 2-Dose Series in Healthy Toddlers 12 Through 15 Months of Age Who Previously Received PCV10 Primary Series in the European Union
Protocol code: C4801002
Sponsor: Pfizer Inc. (Pharmaceutical company). Phase: Therapeutic exploratory (Phase II). Countries: Finland (ended), Poland (ended).
Therapeutic area(s): Diseases [C] - Bacterial Infections and Mycoses [C01]; Diseases [C] - Respiratory Tract Diseases [C08]
Gender: Female, Male. Age: 0-17 years. Enrolment: 100.
Status: Ended. Start date (EU): 2023-11-02. End date (EU): 2024-05-27. End date: 2024-05-28. Decision date: 2023-10-19. Results received: Yes. Last updated: 2024-04-03.
Decision dates by country: PL: 2023-10-23, FI: 2023-10-19

Condition(s): Pneumococcal Infections
Product: Synflorix suspension for injection in pre-filled syringe Pneumococcal polysaccharide conjugate vaccine (adsorbed), Synflorix suspension for injection in pre-filled syringe Pneumococcal polysaccharide conjugate vaccine (adsorbed), PNEUMOCOCCAL POLYSACCHARIDE SEROTYPE 3 CONJUGATED TO CRM197 ADSORBED ON ALUMINIUM PHOSPHATE, Synflorix suspension for injection in pre-filled syringe Pneumococcal polysaccharide conjugate vaccine (adsorbed), Synflorix suspension for injection in pre-filled syringe Pneumococcal polysaccharide conjugate vaccine (adsorbed), Synflorix suspension for injection in pre-filled syringe Pneumococcal polysaccharide conjugate vaccine (adsorbed), Synflorix suspension for injection in pre-filled syringe Pneumococcal polysaccharide conjugate vaccine (adsorbed)

Primary endpoint: Prompted local reactions (redness, swelling, and pain at the injection site), Prompted systemic events (fever, decreased appetite, drowsiness/increased sleep, and irritability), Adverse events (AEs), Serious adverse events (SAEs)
Endpoint(s): Immunoglobulin G (IgG) concentrations for the candidate serotype, Opsonophagocytic activity (OPA) titers for the candidate serotype

Source: https://euclinicaltrials.eu/ctis-public/view/2023-505154-18-00